EU clinical trial 2025-524778-41-00: Oral rifaximin in patients with opioid use disorder (OUD): multicenter clinical trial on the microbiota–gut–brain axis
Sponsor: Fondazione Santa Lucia (Hospital/Clinic/Other health care facility). Phase: Therapeutic exploratory (Phase II). Countries: Italy (not authorised).
Therapeutic area(s): Psychiatry and Psychology [F] - Mental Disorders [F03]
Gender: Female, Male. Age: 18-64 years. Enrolment: 50.
Status: Not authorised. Decision date: 2026-04-29. Results received: No. Last updated: 2026-04-29.

Condition(s): substance use disorder
Product: Normix 200 mg compresse rivestite con film, The placebo is a film-coated oral tablet designed to be comparable in appearance, administration, and handling to the investigational medicinal product (rifaximin 200 mg film-coated tablets), while containing no active pharmaceutical ingredient. The placebo consists exclusively of commonly used pharmaceutical excipients with established safety profiles and is administered solely to maintain blinding in the clinical trial.

Primary endpoint: The primary efficacy endpoints concern the improvement of craving and social disconnection/isolation in OUD paties treated with rifaximin compared with placebo. Specifically: Intensity of opioid craving, Indicators of social isolation/disconnection, Tapering of methadone therapy
Endpoint(s): Improvement in: Intestinal permeability measures, Fecal microbiota characteristics, Adverse events and infections

Source: https://euclinicaltrials.eu/ctis-public/view/2025-524778-41-00